EU clinical trial 2025-523037-25-00: A Phase 2, Multi-center, Randomized, Dose-Ranging, Placebo-Controlled, Double-blind Study of the Relaxin Agonist R2R01 in Patients at High Risk for Cardiac Surgery Associated - Acute Kidney Injury.
Protocol code: R2R01-CSA-AKI-201
Sponsor: River 2 Renal Corp. (Pharmaceutical company). Phase: Therapeutic exploratory (Phase II). Countries: Italy (ongoing, recruiting), Germany (not authorised).
Therapeutic area(s): Diseases [C] - Pathological Conditions, Signs and Symptoms [C23]
Gender: Female, Male. Age: 18-64 years, 65+ years. Enrolment: 440.
Start date (EU): 2026-03-10. Decision date: 2026-03-04. Results received: No. Last updated: 2026-07-13.
Decision dates by country: DE: 2026-03-06, IT: 2026-03-04

Condition(s): Patients at high risk for Cardiac Surgery Associated – Acute Kidney Injury (CSA-AKI) following coronary artery bypass graft (CABG), valve surgery, aortic surgery, or a combination of the above, involving cardiopulmonary bypass (CPB).
Product: SODIO CLORURO BAXTER S.P.A. 0,9% Soluzione per infusione

Primary endpoint: Proportion of subjects developing AKI within 7 days after start of on-pump cardiac surgery based on SCr (AKI of any stage according to KDIGO criteria, see above), Nature, frequency and severity of treatment-emergent adverse events (TEAEs).
Endpoint(s): Severity grade of AKI within 7 days after start of cardiac surgery based on SCr (according to KDIGO criteria, see above)., Duration of AKI defined as the number of days meeting the definition of AKI (according to KDIGO criteria, see above)., Change in SCr and cystatin C (and corresponding eGFR values) at postoperative hours 12, 24, 48, 72, and postoperative Days 7 and 30, versus baseline, Proportion of subjects with a major adverse kidney event (MAKE) defined as all-cause mortality, RRT and/or ≥ 25% sustained reduction of kidney function (i.e., a reduction of eGFR of 25% or more compared to the baseline pre-surgery sample, using the Chronic Kidney Disease-Epidemiology Collaboration (CKD-EPI) equations (with either SCr, CyC, or both) at postoperative Day 7 and at postoperative Day 30, Length of ICU stay (in hours) defined as the duration of stay in the ICU immediately following surgery (or recovery room post-surgery) until ICU discharge, Length of Hospital stay (in days) defined as the duration of stay in the hospital from the day of surgery to hospital discharge, ICU free days and hospital free days, Proportion of subjects readmitted to the hospital at postoperative Day 30

Source: https://euclinicaltrials.eu/ctis-public/view/2025-523037-25-00